EU clinical trial 2023-505573-32-00: Comprehensive Evaluation of Two Second-Line Therapeutic Approaches for Immune Thrombocytopenia (ITP) – a Pragmatic Randomized Controlled Trial - Holistic Study
Protocol code: RGCH006
Sponsor: Ostfold Hospital Trust (Hospital/Clinic/Other health care facility). Phase: Therapeutic confirmatory (Phase III). Countries: Norway (ongoing, recruiting).
Therapeutic area(s): Diseases [C] - Immune System Diseases [C20]
Gender: Female, Male. Age: 18-64 years, 65+ years. Enrolment: 220.
Status: Ongoing, recruiting. Start date (EU): 2025-07-01. Decision date: 2024-01-30. Results received: No. Last updated: 2026-07-08.

Condition(s): Immune Thrombocytopenia (ITP)
Product: AVATROMBOPAG, RITUXIMAB

Primary endpoint: Occurrence of durable platelet response defined as achieving platelet counts > 50 X109/L in > 3 of the bi-weekly measurements between weeks 20 and 28 including the last count without having received any other platelet elevating agents after randomization apart from rescue therapy received before end of week 10.
Endpoint(s): Change in ITP-PAQ (Overall Quality of Life scale) score from baseline to weeks 28 and 78., Change in the FACIT-Fatigue score from baseline to weeks 28 and 78., Occurrence of SROT defined as: 1. a platelet count ≥ 50 X109/L in at least 3 of the 4 planned visits between weeks 36 and 78 including week 78 and; 2. no administration of platelet elevating agent between weeks 36 and 78., Occurrence of treatment failure anytime during the 3 phases defined as: 1. switching to another platelet elevating agent after randomization to avatrombopag/ rituximab and; 2. thrombocytopenia (platelet count <30 X109/L), high risk of bleeding or intolerance of study drug., Incremental treatment cost per incremental quality adjusted life-years (QALY) at end of study: Difference in average treatment cost per patient (use of pre-selected resource units collected for each patient, scaled with pertinent unit cost) per arm over the phase 1 and 2. Difference in average QALYs per patient (SF-36 scores at baseline, weeks 28 and 78 transformed to utility weights multiplied with time under study: area under the curve method). Incremental cost-effectiveness ratio (ICER):, Change in summary scores of SF-36 (v2) questionnaires from baseline to weeks 28 and 78 in all randomized patient., Change in the score of the Treatment Satisfaction Questionnaire for Medication from baseline to weeks 28 and to 78 weeks., Cumulative number of weeks with platelet count ≥ 50 X109/L between randomization and week 78 (including SROT in the Avatrombopag arm) or retreatment. A period of 2 weeks will be deducted after IVIG and 4 weeks after Dexamethasone or Prednisolone including the treatment period., Occurrence of overall response in>3 of the bi-weekly measur between weeks 20 and 28 without the use of rescue therapy after week 10 where overall response is defined as a platelet count ≥30 X109/L and at least doubling of the lowest platelet count measured during the prescreening period of 2 weeks, and absent bleeding in > 80% of the measurements between weeks 20 and 28 without the use of rescue therapy or corticosteroids after week 10, Cumulative dose of dexamethasone /prednisolone, cumulative dose of IVIG, number of platelet transfusions, from time of randomization to treatment failure or week 28., Number and severity of WHO bleeding events. Change in Khellaf score from baseline to weeks 28 and 78., Occurrence and severity of treatment emergent adverse events Occurrence and severity of adverse events of special interest including infections leading to hospitalization or death, arterial and venous thrombosis, platelet overshooting and bone marrow fibrosis (bone marrow biopsy showing MF2 or higher).

Source: https://euclinicaltrials.eu/ctis-public/view/2023-505573-32-00